EU clinical trial 2026-525917-29-00: Early TRIPLE versus dual LIPID lowering treatment in peOple with atherosclerotic cardiovascular disease and hypercholesterolemia Undergoing elecTive revascularisation - The randomized, controlled, open-label, parallel group TRIPLE-LIPID-OUT trial
Protocol code: KMT-2026-01
Sponsor: Medical University Of Graz (Educational Institution). Phase: Therapeutic use (Phase IV). Countries: Germany (authorised, recruitment pending), Austria (authorised, recruiting).
Therapeutic area(s): Diseases [C] - Cardiovascular Diseases [C14]; Diseases [C] - Nutritional and Metabolic Diseases [C18]
Gender: Female, Male. Age: 18-64 years, 65+ years. Enrolment: 160.
Start date (EU): 2026-07-28. Decision date: 2026-07-14. Results received: No. Last updated: 2026-07-17.
Decision dates by country: AT: 2026-07-17, DE: 2026-07-14

Condition(s): Peripheral arterial disease, Coronary artery atherosclerotic heart disease, Hypercholesterolaemia
Product: Ezegelan 10 mg-Tabletten, Nustendi 180 mg/10 mg film-coated tablets, Rosuvalan 20 mg-Filmtabletten

Primary endpoint: Difference in the percentage of people achieving an LDL-C <55 mg/dl at 12 weeks (V2) between the two study groups
Endpoint(s): Difference in the percentage of people achieving an LDL-C <55 mg/dl at 12 months follow up between the two study groups, Difference in mean change of LDL-C levels between the two study groups from V1 to V2, Difference in mean change of LDL-C levels between the two study groups from V1 to 12 months, Difference in mean change of Apo-B100 levels between the two study groups from V1 to V2, Difference in mean change of Apo-B100 levels between the two study groups from V1 to 12months, Difference in mean change of Apo-A1 levels between the two study groups from V1 to V2, Difference in mean change of Apo-A1 levels between the two study groups from V1 to 12 months, Difference in mean change of apolipoprotein (a) levels between the two study groups from V1 to V2, Difference in mean change of apolipoprotein (a) levels between the two study groups from V1to 12 months, Difference in mean change of hs-CRP levels between the two study groups from V1 to V2, Difference in mean change of hs-CRP levels between the two study groups from V1 to 12 months, Difference in number of severe adverse events (SAEs) between the two groups from V1 over 12 months, Difference in the Depression Score (HADS-D) between the two groups from V1 to V2, Difference in the Depression Score (HADS-D) between the two groups from V1 to 12 months, Difference in the psychological flexibility between the two groups from V1 to V2, Difference in the psychological flexibility between the two groups from V1 to 12 months, Difference in the number of adverse events between the two groups from V1 to V2, Difference in the number of adverse events between the two groups from V1 to 12 months

Source: https://euclinicaltrials.eu/ctis-public/view/2026-525917-29-00